EU clinical trial 2024-517008-12-00: GEM21menos65. A Phase III trial for NDMM patients who are candidates for ASCT comparing Extended VRD plus Early Rescue Intervention vs Isatuximab-VRD vs Isatuximab-V-Iberdomide-D.
Protocol code: GEM21menos65
Sponsor: Fundacion PETHEMA (Patient organisation/association). Phase: Therapeutic confirmatory (Phase III). Countries: Spain (ongoing, recruitment ended).
Therapeutic area(s): Diseases [C] - Hemic and Lymphatic Diseases [C15]
Gender: Female, Male. Age: 18-64 years. Enrolment: 480.
Status: Ongoing, recruitment ended. Start date (EU): 2022-10-14. Decision date: 2024-10-21. Results received: No. Last updated: 2026-06-15.

Condition(s): Newly-diagnosed multiple myeloma (NDMM)
Product: Revlimid 15 mg hard capsules, VELCADE 3.5 mg powder for solution for injection, Isatuximab, Iberdomide, Revlimid 10 mg hard capsules, Iberdomide, ISATUXIMAB, Revlimid 5 mg hard capsules, Revlimid 25 mg hard capsules, Iberdomide, DEXAMETHASONE

Primary endpoint: Improvement in the percentage of patients MRD-negative in Arm A vs. Arm B when considering B1 endpoint. B1 endpoint: VRD extended impact only, without considering ERI impact: any patient that require an ERI per protocol before finishing the 18 cycles + ASCT, will be considered MRD-positive at that time, independently of the ERI impact, Non-inferiority in the percentage of patients MRD-negative in Arm A vs. Arm B when considering B2 endpoint. B2 endpoint: VRD extended plus ERI impact: any patient who achieves MRD negativity with ERI before finishing the 18 cycles + ASCT will be considered MRD-negative at that time.

Source: https://euclinicaltrials.eu/ctis-public/view/2024-517008-12-00